EU clinical trial 2024-518205-17-00: A Phase II/III Randomized, Open-Label Clinical Study of Napabucasin in Combination with Weekly Paclitaxel and Low-dose Gemcitabine in Patients with Metastatic Pancreatic Cancer Following Chemotherapy Failure
Protocol code: STEMNESS-PANC
Sponsor: 1globe Health Institute LLC (Pharmaceutical company). Phase: Phase II and Phase III (Integrated). Countries: France (ongoing, recruitment ended), Spain (ongoing, recruitment ended).
Therapeutic area(s): Diseases [C] - Neoplasms [C04]
Gender: Female, Male. Age: 18-64 years, 65+ years. Enrolment: 84.
Status: Ongoing, recruitment ended. Start date (EU): 2022-05-27. Decision date: 2024-11-12. Results received: No. Last updated: 2025-12-10.
Decision dates by country: FR: 2024-11-19, ES: 2024-11-12

Condition(s): Histologically or cytologically confirmed advanced pancreatic adenocarcinoma that is metastatic.
Product: Napabucasin, Bendatax 6 mg/ ml, Bendacitabin 38 mg/ml Pulver zur Herstellung einer Infusionslösung

Primary endpoint: Phase II Part of the Study: Progression Free Survival (PFS), Phase II Part of the Study: Safety in the general study population, Phase III Part of the Study: Overall Survival (OS) in the general study population.
Endpoint(s): Phase II Part of the Study: •Disease control rate (DCR) in the general study population, Phase II Part of the Study: •Objective response rate (ORR) in the general study population, Phase III Part of the Study: •PFS in the general study population, Phase III Part of the Study: •ORR and DCR in the general study population, Phase III Part of the Study: •OS, PFS, ORR and DCR in the predefined biomarker positive population, Phase III Part of the Study: •Safety, Phase III Part of the Study: •Quality of Life

Source: https://euclinicaltrials.eu/ctis-public/view/2024-518205-17-00